EU clinical trial 2024-513495-17-00: An open-label, DDI study to investigate the effects of amlitelimab on the PK of selected cytochrome P450 substrates
Protocol code: INT18404
Sponsor: Sanofi-Aventis Recherche & Developpement (Pharmaceutical company). Phase: Human Pharmacology (Phase I)- Other. Countries: Germany (ended), Bulgaria (ended).
Therapeutic area(s): Diseases [C] - Skin and Connective Tissue Diseases [C17]
Gender: Female, Male. Age: 18-64 years. Enrolment: 30.
Status: Ended. Start date (EU): 2024-11-20. End date (EU): 2026-04-02. Decision date: 2024-11-01. Results received: No. Last updated: 2026-03-24.
Decision dates by country: BG: 2025-03-11, DE: 2024-11-01

Condition(s): Dermatitis atopic

Source: https://euclinicaltrials.eu/ctis-public/view/2024-513495-17-00